EU clinical trial 2024-510719-31-00: A Randomized, Placebo-controlled, Double-blind, Phase 3 Clinical Study to Investigate the Efficacy and Safety of Fezolinetant for Treatment of Moderate to Severe Vasomotor Symptoms (Hot Flashes) in Women with Stage 0 to 3 Hormone Receptor-positive Breast Cancer Who Are Receiving Adjuvant Endocrine Therapy
Protocol code: 2693-CL-1303
Sponsor: Astellas Pharma Global Development Inc. (Pharmaceutical company). Phase: Therapeutic confirmatory (Phase III). Countries: Hungary (ongoing, recruitment ended), Denmark (ongoing, recruitment ended), Italy (ongoing, recruitment ended), Czechia (ongoing, recruitment ended), Germany (ongoing, recruitment ended), France (ongoing, recruitment ended), Poland (ongoing, recruitment ended), Spain (ongoing, recruitment ended), Netherlands (ongoing, recruitment ended).
Therapeutic area(s): Diseases [C] - Hormonal diseases [C19]
Gender: Female. Age: 18-64 years, 65+ years. Enrolment: 383.
Status: Ongoing, recruitment ended. Start date (EU): 2025-01-24. Decision date: 2024-10-01. Results received: No. Last updated: 2026-07-21.
Decision dates by country: ES: 2024-10-03, NL: 2025-01-21, PL: 2024-10-07, CZ: 2024-10-02, DK: 2024-10-01, FR: 2024-10-07, DE: 2024-10-04, HU: 2024-10-01, IT: 2024-10-03

Condition(s): Moderate to Severe Vasomotor Symptoms (VMS)
Product: Placebo for fezolinetant film-coated tablets 45 mg, fezolinetant

Primary endpoint: Co-primary endpoints: effect of fezolinetant on the following 4 co-primary variables: Change in the frequency of moderate to severe VMS from baseline (BL) to week 4;, Change in the frequency of moderate to severe VMS from BL to week 12;, Change in the severity of moderate to severe VMS from BL to week 4;, Change in the severity of moderate to severe VMS from BL to week 12.
Endpoint(s): Change in the Menopause-specific Quality of Life Questionnaire (MENQOL) VMS domain score from BL to week 12; Change in the Patient-reported Outcomes Measurement Information System Sleep Disturbance Short Form (PROMIS SD SF) 8b Total (raw) Score from BL to week 12., Change in the frequency of moderate to severe VMS from BL to week 24; Change in the severity of moderate to severe VMS from BL to week 24., Incidence and severity of treatment-emergent adverse events (TEAEs) including adverse events of special interest (AESIs), clinical laboratory assessments, vital signs and ECG., Change in the frequency of moderate to severe VMS from BL to weeks 1 to 3 and from BL to weeks 5 to 11; Change in the severity of moderate to severe VMS from BL to weeks 1 to 3 and from BL to weeks 5 to 11., Percent reduction of ≥ 50%, ≥ 75% and 100% in the frequency of moderate to severe VMS from BL to weeks 1, 4, 8 and 12., Model-based steady-state population PK parameters for fezolinetant (CL/F, Vc/F) and derived exposure-measures of fezolinetant (Cavg and/or Ctrough) with tamoxifen or aromatase inhibitors., Model-based steady-state population PK parameters for tamoxifen and its metabolites (4-OH tamoxifen, N-desmethyltamoxifen and endoxifen) and aromatase inhibitors (CL/F, Vc/F) and derived exposure-measures (Cavg and/or Ctrough) with and without fezolinetant co-administration., 8a. Change in the MENQOL Total Score from BL to weeks 4, 8, 12 and 24; Change in the MENQOL domain scores from BL to weeks 4, 8, 12 and 24;, 8b. Change in the PROMIS SD SF 8b Total (raw) Score from BL to weeks 4, 8, 12 and 24;, 8c. Scores on the Patient Global Impression of Change (PGI-C) VMS at weeks 4, 8, 12 and 24; Change in the Patient Global Impression of Severity (PGI-S) VMS Score from BL to weeks 4, 8, 12 and 24;, 8d. Scores on the PGI-C sleep disturbance (SD) at weeks 4, 8, 12 and 24; Change in the PGI-S SD Score from BL to weeks 4, 8, 12 and 24., 8e PGI-S SD response (at least 2 levels of improvement from BL) at weeks 4, 8, 12 and 24.

Source: https://euclinicaltrials.eu/ctis-public/view/2024-510719-31-00